EU clinical trial 2022-501935-18-00: "Abdominal Aortic Aneurysm Stabilization with Truncal Cells: Controlled Clinical Trial with Historical Cohorts."
Protocol code: HULP-STEM-EVAR-2020
Sponsor: Grupo Dermatologico Y Estetico Pedro Jaen S.A. (Hospital/Clinic/Other health care facility). Phase: Therapeutic exploratory (Phase II). Countries: Spain (ongoing, recruiting).
Therapeutic area(s): Not possible to specify
Gender: Female, Male. Age: 18-64 years, 65+ years. Enrolment: 8.
Status: Ongoing, recruiting. Start date (EU): 2024-06-12. Decision date: 2024-02-16. Results received: No. Last updated: 2024-06-03.
Decision dates by country: ES: 2024-06-03

Condition(s): Patients with abdominal aortic aneurysm undergoing endovascular surgical repair.
Product: Células mesenquimales troncales alogénicas de tejido adiposo expandidas.

Primary endpoint: Proportion of procedure-related adverse events occurring throughout the study., Proportion of adverse events related to allogeneic adipose tissue-derived mesenchymal stem cell infusion occurred throughout the study., Proportion of patients with major adverse cerebral and cardiovascular events (MACCE) within 12 months after treatment.
Endpoint(s): Reduction of the size of the aneurysm sac in the imaging tests performed during follow-up (CT and Doppler echo). A reduction in the maximum diameter of the aneurysm sac greater than or equal to 5mm in a period of 6 months is considered significant., Percentage of patients with stent migration compared to the historical cohort., Percentage of patients with presence of leaks on control CT at 1 month and 1 year compared to the historical cohort., Reoperation rate at 1 year compared to historical cohort., Hospital admission rate compared to the historical cohort., Assessment of change in quality of life: specific quality of life assessment survey at one month and one year after treatment with respect to baseline. A 10% change in quality of life scores is considered clinically relevant.

Source: https://euclinicaltrials.eu/ctis-public/view/2022-501935-18-00